EU clinical trial 2024-511813-39-00: A Phase 3 Randomized, Double-blind, Multicenter, Global Study of Monalizumab or Placebo in Combination With Cetuximab in Participants With Recurrent or Metastatic Squamous Cell Carcinoma of the Head and Neck Previously Treated With an Immune Checkpoint Inhibitor
Protocol code: D7310C00001
Sponsor: AstraZeneca AB (Pharmaceutical company). Phase: Therapeutic confirmatory (Phase III). Countries: Germany (ended).
Therapeutic area(s): Diseases [C] - Neoplasms [C04]
Gender: Female, Male. Age: 18-64 years, 65+ years. Enrolment: 16.
Status: Ended. Start date (EU): 2021-03-04. End date (EU): 2024-10-29. Decision date: 2024-06-27. Results received: No. Last updated: 2024-11-13.

Condition(s): Patients With Recurrent or Metastatic Squamous Cell Carcinoma of the Head and Neck Previously Treated With an Immune Checkpoint Inhibitor
Product: Monalizumab, Isotone Kochsalz-Lösung 0,9 % Braun Infusionslösung, CETUXIMAB

Primary endpoint: Overall survival, defined as the time from the date of randomization until date of death due to any cause.
Endpoint(s): Overall survival, defined as the time from the date of randomization until date of death due to any cause, PFS is defined as time from randomization until disease progression, per RECIST 1.1 as assessed by the investigator at local site or death due to any cause, whichever occurs first., ORR is defined as the proportion of participants with measurable disease who have a confirmed CR or PR, as determined by the investigator at local site per RECIST 1.1., DoR is defined as the time from the date of first documented response until date of documented disease progression or death in the absence of disease progression., Patient questionnaires regarding wellbeing and symptom change in baseline scores across visits, Concentration of monalizumab in the blood, Presence of antibodies to monalizumab in the blood, Measurement of specific biomarkers in the tumor sample(s), AEs, vital signs, clinical laboratory results, ECGs

Source: https://euclinicaltrials.eu/ctis-public/view/2024-511813-39-00